EU clinical trial 2022-502706-33-00: LONG-TERM FOLLOW-UP STUDY OF EARLY STAGE BREAST CANCER PATIENTS INCLUDED IN GEICAM STUDIES
Protocol code: GEICAM/2016-03
Sponsor: Grupo Espanol De Investigacion En Cancer De Mama (Patient organisation/association). Phase: Therapeutic use (Phase IV). Countries: Spain (ongoing, recruiting).
Therapeutic area(s): Diseases [C] - Neoplasms [C04]
Gender: Female. Age: 18-64 years, 65+ years. Enrolment: 8000.
Status: Ongoing, recruiting. Start date (EU): 2018-01-10. Decision date: 2023-07-24. Results received: No. Last updated: 2026-06-10.

Condition(s): Patients with invasive breast cancer in early stages
Product: Abraxane 5 mg/ml powder for dispersion for infusion., Aromasil 25 mg comprimidos recubiertos, TAXOTERE 20 mg/0.5 ml concentrate and solvent for solution for infusion, Ofev 100 mg soft capsules, Zoladex 3,6 mg implante en jeringa precargada, Myocet liposomal 50 mg powder, dispersion and solvent for concentrate for dispersion for infusion., Carboplatin 10 mg/ml Concentrate for Solution for Infusion, Paclitaxel Hospira 6 mg/ml concentrado para solución para perfusión EFG, Faslodex 250 mg solution for injection., Herceptin 150 mg powder for concentrate for solution for infusion, Gemcitabina Accord 2000 mg polvo para solución para perfusión, Xeloda 500 mg film-coated tablets, LAPATINIB

Primary endpoint: Dates of disease relapse (local, regional or distant) and second primary tumors. Event Free Survival (EvFS) in neoadjuvant studies. Event Free Survival (EFS) in adjuvant studies.
Endpoint(s): Death date and whether or not it is related to breast cancer. Overall Survival (OS).

Source: https://euclinicaltrials.eu/ctis-public/view/2022-502706-33-00